EU clinical trial 2024-516178-31-00: DAHANCA 30; Et randomiseret non-inferiority studie af hypoxi-profilvejledt nimorazolbehandling i forbindelse med primær strålebehand-ling af planocellulære hoved-halskarcinomer
Protocol code: DAHANCA 30
Sponsor: Region Midtjylland (Hospital/Clinic/Other health care facility). Phase: Therapeutic confirmatory (Phase III). Countries: Norway (ongoing, recruitment ended), Denmark (ongoing, recruitment ended).
Therapeutic area(s): Diseases [C] - Neoplasms [C04]
Gender: Female, Male. Age: 18-64 years, 65+ years. Enrolment: 1262.
Status: Ongoing, recruitment ended. Start date (EU): 2016-08-24. Decision date: 2024-11-29. Results received: No. Last updated: 2024-11-29.
Decision dates by country: DK: 2024-11-29, NO: 2024-11-29

Condition(s): Head and neck squamous cell carcinoma (HNSCC)
Product: Nimoral tablets 500 mg, CISPLATIN

Primary endpoint: Locoregional control after radiotherapy (not including possible salvage treatment).
Endpoint(s): Local control (T-site), regional control (N-site), distant metastases, locoregional control after salvage treatment, overall survival (survival, disease- free survival, disease-specific survival), acute or late morbidity

Source: https://euclinicaltrials.eu/ctis-public/view/2024-516178-31-00